EU clinical trial 2024-515921-27-00: Open-Label, Phase 2 Study to Assess the Safety of Mogamulizumab Given Every 4 Weeks Following Induction in Participants with Relapsed/Refractory Cutaneous T-Cell Lymphoma (CTCL)
Protocol code: 0761-016
Sponsor: Kyowa Kirin Inc. (Pharmaceutical company). Phase: Therapeutic exploratory (Phase II). Countries: Spain (ended), France (ended).
Therapeutic area(s): Diseases [C] - Skin and Connective Tissue Diseases [C17]
Gender: Female, Male. Age: 18-64 years, 65+ years. Enrolment: 8.
Status: Ended. Start date (EU): 2021-01-13. End date (EU): 2025-01-31. End date: 2025-04-11. Decision date: 2024-10-01. Results received: Yes. Last updated: 2024-10-16.
Decision dates by country: FR: 2024-10-16, ES: 2024-10-01

Condition(s): Mycosis fungoides/Sezary syndrome recurrent
Product: POTELIGEO 4 mg/mL concentrate for solution for infusion

Primary endpoint: •Percentage of participants experiencing treatment-emergent adverse events. • Changes in laboratory analyses, physical examinations, vital signs, and ECGs.
Endpoint(s): • Serum concentrations of mogamulizumab and other PK parameters. • ORR and compartment response will be assessed as described by Olsen (2011). • DOR will be calculated from first response to progression or death • Detection of anti-drug antibodies (ADAs) to mogamulizumab and incidence of ADAs. • Tissue samples will be assessed for changes in CCR4, CD4, and CD8 expression., • Blood samples will be assessed for circulating malignant T-cells

Source: https://euclinicaltrials.eu/ctis-public/view/2024-515921-27-00